EU clinical trial 2024-512669-15-00: U3P study - Upadacitinib in Psoriatic Arthritis Pain Processing
Sponsor: Universitaetsklinikum Erlangen AöR (Hospital/Clinic/Other health care facility). Phase: Therapeutic use (Phase IV). Countries: Germany (ended).
Therapeutic area(s): Diseases [C] - Immune System Diseases [C20]
Gender: Female, Male. Age: 18-64 years, 65+ years. Enrolment: 20.
Status: Ended. Start date (EU): 2022-03-24. End date (EU): 2025-01-22. Decision date: 2024-03-20. Results received: Yes. Last updated: 2024-03-20.

Condition(s): Psoriatic arthritis
Product: RINVOQ 15 mg prolonged-release tablets

Primary endpoint: BOLD signal voxel count at week 1 and week 12 compared to baseline

Source: https://euclinicaltrials.eu/ctis-public/view/2024-512669-15-00